EU clinical trial 2023-509055-14-00: Prospective Evaluation of Ivosidenib Maintenance Following Allogeneic Stem Cell Transplantation (alloSCT) In Patients with Acute Myeloid Leukemia (AML) or High-Risk Myelodysplastic Neoplasia (HR-MDS) with IDH1 Mutation (PIVOT)
Protocol code: TUD-PIVOT1-085
Sponsor: Technische Universitat Dresden (Educational Institution). Phase: Therapeutic exploratory (Phase II). Countries: Germany (ongoing, recruiting).
Therapeutic area(s): Diseases [C] - Neoplasms [C04]
Gender: Female, Male. Age: 18-64 years, 65+ years. Enrolment: 76.
Status: Ongoing, recruiting. Start date (EU): 2025-06-17. Decision date: 2025-04-11. Results received: No. Last updated: 2026-08-07.
Decision dates by country: DE: 2025-04-16

Condition(s): myelodysplastic neoplasia (MDS), acute myeloid leukemia (AML)
Product: Tibsovo 250 mg film-coated tablets

Primary endpoint: Rate of event-free survival (EFS) at two years after study inclusion. Events are defined as death from any cause or disease relapse defined as reappearance of leukemic blasts in peripheral blood or ≥ 5% bone marrow blasts or development of extramedullary disease as defined according to 1 or end of or initiation of any new anti-cancer therapy.
Endpoint(s): Rate of overall survival (OS) at two years after study inclusion (written informed consent)., EFS and OS as time-to-event analysis including follow-up., Rate of complete molecular remissions (CRMRD-) as defined by international consensus guidelines at 6, 12 and 24 months after study inclusion., MRD conversion rate from positive (CRMRD+) to negative (CRMRD−) as defined by international consensus guidelines among subjects with measurable residual disease at baseline., Cumulative incidence of higher grade acute GvHD defined as new onset of or increase in severity to grade III-IV aGVHD as defined by investigator following international expert consensus guidelines ., Cumulative incidence and maximal grade (according to international expert consensus guidelines) of chronic GvHD requiring systemic treatment within one year after alloSCT., Cumulative incidence of AEs/SAEs Grade ≥3 or leading to dose reduction/discontinuation of study treatment., Cumulative incidences of non-relapse mortality within 100 days and 2 years from study inclusion defined as death that was not proceeded by recurrent or progressive malignancy., Cumulative incidence of relapse mortality within 2 years from study inclusion., Number of patients who require dose reductions or have to stop study treatment due to toxicity reasons.

Source: https://euclinicaltrials.eu/ctis-public/view/2023-509055-14-00